EU clinical trial 2024-520014-22-00: A Phase 3, Randomized, Open-label Study of Sacituzumab Tirumotecan (MK-2870) Versus Investigator’s Choice of Non-platinum Chemotherapy in Participants with Pretreated Locally Advanced/Metastatic Urothelial Carcinoma
Protocol code: MK-2870-031
Sponsor: Merck Sharp & Dohme LLC (Pharmaceutical company). Phase: Therapeutic confirmatory (Phase III). Countries: Netherlands (ongoing, recruiting), Greece (ongoing, recruiting), Italy (ongoing, recruiting), Germany (authorised, recruitment pending), Spain (ongoing, recruiting), Belgium (ongoing, recruiting), Sweden (ongoing, recruiting), France (ongoing, recruiting).
Therapeutic area(s): Diseases [C] - Neoplasms [C04]
Gender: Female, Male. Age: 18-64 years, 65+ years. Enrolment: 265.
Start date (EU): 2026-04-22. Decision date: 2026-04-20. Results received: No. Last updated: 2026-04-25.
Decision dates by country: BE: 2026-04-20, FR: 2026-04-21, DE: 2026-04-25, GR: 2026-04-20, IT: 2026-04-21, ES: 2026-04-24, SE: 2026-04-20, NL: 2026-04-20

Condition(s): Locally advanced/metastatic urothelial carcinoma
Product: DOCETAXEL, MK-2870, VINFLUNINE, PACLITAXEL, MK-2870

Primary endpoint: Overall Survival (OS)
Endpoint(s): Progression-Free Survival (PFS), Objective Response Rate (ORR), Duration of Response (DOR), Number of Participants Who Experience an Adverse Event (AE), Number of Participants Who Discontinue Study Treatment Due to an AE, Change From Baseline in European Organisation for Research and Treatment of Cancer Quality of Life Questionnaire-Core 30 (EORTC QLQ-C30) Global Health Status/Quality of Life (Items 29 and 30) Combined Score, Change From Baseline in EORTC QLQ-C30 Physical Functioning (Items 1-5) Combined Score, Change From Baseline in EORTC QLQ-C30 Role Functioning (Items 6 and 7) Combined Score, Change From Baseline in EORTC QLQ-C30 Fatigue (Items 10, 12, and 18) Combined Score, Change From Baseline in EORTC QLQ-C30 Nausea/Vomiting (Items 14 and 15) Combined Score, Change From Baseline in EORTC QLQ-C30 Diarrhea (Item 17) Score

Source: https://euclinicaltrials.eu/ctis-public/view/2024-520014-22-00